EU clinical trial 2024-519366-52-00: Pilot Study to Evaluate Safety and Efficacy of PolyCore, a Ternary Combination of Xylitol, L-Carnitine and Polydextrin, to Treat End-Stage Kidney Disease Patients Starting Peritoneal Dialysis (EXCITE)
Protocol code: IP-001-24
Sponsor: Iperboreal Pharma S.r.l. (Pharmaceutical company). Phase: Therapeutic exploratory (Phase II). Countries: Italy (ongoing, recruiting).
Therapeutic area(s): Diseases [C] - Male Urogenital Diseases [C12]; Diseases [C] - Female Urogenital Diseases and Pregnancy Complications [C13]
Gender: Female, Male. Age: 18-64 years, 65+ years. Enrolment: 28.
Status: Ongoing, recruiting. Start date (EU): 2026-02-17. Decision date: 2025-06-24. Results received: No. Last updated: 2026-04-29.

Condition(s): End-Stage Kidney Disease
Product: PolyCore

Primary endpoint: Adverse Events (during the whole study), Physical Examination (at every visit), Vital Signs and body weight (at every visit), Blood chemistry and hematology (at every visit), 24h diuresis analysis (at every visit), 24h dialysate analysis (at every visit), Weekly Kt/V urea (evaluated at every visit), Residual kidney function (at every visit)
Endpoint(s): Post-baseline profile of weekly Kt/V urea (at every visit), Peritoneal ultrafiltration (at every visit and daily by patient diary), Peritoneal and total sodium removal (at every visit), Glycemic and lipidic parameters (at every visit), Peritoneal clearances: creatinine, phosphate, B2-microglobulin, (at every visit), Quality of Life: KDQOL-SF (V2, V4), N° of patients who dropped-out from the study for safety and efficacy reasons

Source: https://euclinicaltrials.eu/ctis-public/view/2024-519366-52-00